EU clinical trial 2023-508456-18-00: Ramdomized non-inferiority clinical trial to evaluate the safety and efficacy of short duration therapy for non complicated enterococcal bacteremia.
Protocol code: INTENSE
Sponsor: Fundacion Publica Andaluza Para La Gestion De La Investigacion En Salud De Sevilla (Laboratory/Research/Testing facility). Phase: Therapeutic use (Phase IV). Countries: Spain (ongoing, recruitment ended).
Therapeutic area(s): Diseases [C] - Bacterial Infections and Mycoses [C01]
Gender: Female, Male. Age: 18-64 years, 65+ years. Enrolment: 284.
Status: Ongoing, recruitment ended. Start date (EU): 2024-04-29. Decision date: 2024-04-29. Results received: No. Last updated: 2025-08-08.

Condition(s): Uncomplicated bacteremia caused by E. faecalis or E. faecium.
Product: PIPERACILLIN AND BETA-LACTAMASE INHIBITOR, VANCOMYCIN, Linezolid Normon 600 mg comprimidos recubiertos con película EFG, AMOXICILLIN AND BETA-LACTAMASE INHIBITOR, VANCOMYCIN, AMOXICILLIN, AMOXICILLIN SODIUM, AMPICILLIN, PIPERACILLIN AND BETA-LACTAMASE INHIBITOR, AMOXICILLIN, AMPICILLIN, AMOXICILLIN AND BETA-LACTAMASE INHIBITOR, DAPTOMYCIN, LINEZOLID, Amoxicilina/Ácido clavulánico Sandoz 1.000 mg/200 mg polvo para solución inyectable y para perfusión EFG, Linezolid 600 mg film-coated tablets, DAPTOMYCIN, LINEZOLID

Primary endpoint: Clinical success at TOC in the ITTP.
Endpoint(s): Rates of diagnosis of relapse or infective endocarditis in OCD and follow-up visit in the clinically evaluable population (CEP)., Survival in OCD and follow-up visit., Length of hospital stay, Duration of IV and total therapy in CEP, Infection with C. difficile., Adverse events and severity, Secondary infections, Change in SOFA score in OCD and follow-up visit.

Source: https://euclinicaltrials.eu/ctis-public/view/2023-508456-18-00